EU clinical trial 2023-506971-89-00: A Phase III Prospective, Multicenter, Open-label Study to Assess Diagnostic Efficacy of a Novel 18F-labelled Tracer, SYN2, for Positron Emission Tomography in Subjects with Suspected Coronary Artery Disease
Protocol code: SAFER3
Sponsor: Syn2bio S.A. (Pharmaceutical company). Phase: Therapeutic confirmatory (Phase III). Countries: Poland (ongoing, recruiting), Italy (ongoing, recruiting), Finland (ongoing, recruiting), Germany (ongoing, recruiting), Netherlands (ongoing, recruiting).
Therapeutic area(s): Diseases [C] - Cardiovascular Diseases [C14]
Gender: Female, Male. Age: 18-64 years, 65+ years. Enrolment: 220.
Status: Ongoing, recruiting. Start date (EU): 2024-01-25. Decision date: 2023-11-22. Results received: No. Last updated: 2026-07-13.
Decision dates by country: NL: 2024-07-02, IT: 2024-06-28, FI: 2024-06-27, DE: 2024-06-10, PL: 2023-11-22

Condition(s): Coronary Artery Disease
Product: Rapiscan 400 microgram solution for injection, Adenosine 6 mg/2 ml solution for injection, SYN2

Primary endpoint: Diagnostic performance in terms of sensitivity and specificity of qualitative expert assessment of SYN2 PET MPI against the reference standard.
Endpoint(s): Diagnostic performance in terms of the area under the receiver operating characteristics (AUC-ROC) of quantitative analysis of SYN2 PET MPI against the reference standard in diagnosis of significant CAD. AUC ROC will be estimated by the trapezoidal rule., Adverse events and reportable serious adverse rates during the resting study as defined by the NCI Common Toxicity Criteria for Adverse Events; CTCAE v.5.0, including but not limited to changes in laboratory parameters, ECG parameters, physical examination, and vital signs., Diagnostic performance in terms of sensitivity and specificity of qualitative expert assessment of SYN2 PET MPI in detection of CAD against the reference standard of ICA alone and CAD defined by >70% stenosis in a major branch in subjects with suspected CAD., Diagnostic performance in terms of the area under the receiver operating characteristics (AUC-ROC) of quantitative perfusion analysis of SYN2 PET MPI in the detection of significant CAD by ICA alone and CAD defined by >70% stenosis in a major branch.

Source: https://euclinicaltrials.eu/ctis-public/view/2023-506971-89-00